EU clinical trial 2025-522051-26-00: A Phase 3, Randomized, Double-blind, Placebo-controlled, 3-Part Study to Evaluate the Efficacy and Safety of Orally Administered Deucrictibant XR Tablet for Prophylaxis and Deucrictibant Soft Capsule for On-demand Treatment of Angioedema Attacks in Adults with Acquired Angioedema due to C1 Inhibitor Deficiency
Protocol code: PHA022121-C308
Sponsor: Pharvaris Netherlands B.V. (Pharmaceutical company). Phase: Therapeutic confirmatory (Phase III). Countries: Hungary (authorised, recruiting), Spain (ongoing, recruiting), Austria (authorised, recruiting), Germany (ongoing, recruiting), Poland (ongoing, recruiting), Netherlands (ongoing, recruiting), France (ongoing, recruiting), Italy (ongoing, recruiting), Bulgaria (ongoing, recruiting).
Therapeutic area(s): Diseases [C] - Immune System Diseases [C20]
Gender: Female, Male. Age: 18-64 years, 65+ years. Enrolment: 18.
Start date (EU): 2026-04-23. Decision date: 2026-03-17. Results received: No. Last updated: 2026-05-15.
Decision dates by country: AT: 2026-03-22, BG: 2026-03-19, FR: 2026-03-19, DE: 2026-03-17, HU: 2026-03-19, IT: 2026-03-18, ES: 2026-03-18, NL: 2026-03-19, PL: 2026-03-23

Condition(s): Acquired Angioedema due to C1 Inhibitor Deficiency
Product: Placebo for Deucrictibant 40mg extended release tablets, Deucrictibant (PHA-022121), Deucrictibant (PHA-022121), Placebo for Deucrictibant 20mg soft capsules

Primary endpoint: 1. Part 1 Time-normalized (per 4 weeks) number of Investigator-confirmed AAE-C1INH attacks during the 12-week Prophylaxis Treatment Phase (Day 1 through Day 84), 2. Part 2 Time to symptom relief defined as PGI-C rating of at least ‘better’ sustained within 12 hours post-treatment, 3. Part 3 Incidence of TEAEs, treatment- emergent AESIs, and SAEs, 4. Part 3 Change from baseline in clinical laboratory, vital sign, physical examination, and electrocardiogram (ECG) parameters
Endpoint(s): 1. Part 1 Proportion of participants who are AAE-C1INH attack-free during the 12-week Prophylaxis Treatment Phase, 2. Part 1 Time-normalized number of Investigator-confirmed AAE-C1INH attacks treated with on-demand medication during the 12-week Prophylaxis Treatment Phase, 3. Part 1 Time-normalized number of Investigator-confirmed moderate or severe AAE-C1INH attacks during the 12-week Prophylaxis Treatment Phase, 4. Part 1 Time-normalized number of Investigator-confirmed severe AAE-C1INH attacks during the 12-week Prophylaxis Treatment Phase, 5. Part 1 Proportion of participants achieving ≥50% reduction in AAE-C1INH attack rate relative to baseline during the 12-week Prophylaxis Treatment Phase, 6. Part 1 Proportion of participants achieving ≥70% reduction in AAE-C1INH attack rate relative to baseline during the 12-week Prophylaxis Treatment Phase, 7. Part 1 Proportion of participants achieving ≥90% reduction in AAE-C1INH attack rate relative to baseline during the 12-week Prophylaxis Treatment Phase, 8. Part 1 Incidence of TEAEs, treatment-emergent AESIs, and SAEs, 9. Part 1 Change from baseline in clinical laboratory, vital sign, physical examination, and ECG parameters, 10. Part 1 Deucrictibant and deucrictibant metabolites pre-dose plasma concentrations at Week 6 and Week 12, 11. Part 1 Change from baseline in Angioedema Quality of Life (AE-QoL) total score, functioning domain score, and fears/shame domain score at Weeks 4, 8, and 12, 12. Part 1 Change from baseline in Angioedema Control Test 4-week version (AECT-4wk) at Week 12, 13. Part 1 Patient Global Assessment-Change (PGA-C) at Week 12 compared with Patient Global Assessment-Status (PGA-S) at baseline, 14. Part 1 Change from baseline in EuroQol 5 Dimension 5 Level (EQ-5D-5L) at Week 12, 1. Part 2 Time to complete symptom resolution, defined as achieving Patient Global Impression of Severity (PGI-S) rating of “no symptoms” sustained within 24 hours post-treatment, 2. Part 2 Time to symptom relief defined as PGI-S rating of at least 1 point reduction sustained within 12 hours post-treatment, 3. Part 2 Proportion of study drug-treated attacks achieving complete symptom resolution, defined as achieving PGI-S rating of “no symptoms” at 24 hours post-treatment, 4. Part 2 Time to onset of symptom relief, defined as PGI-C rating of at least “a little better” sustained within 12 hours post-treatment, 5. Part 2 Time to End of Progression (EoP) in attack symptoms within 12 hours, with EoP time defined as the earliest post-treatment timepoint after which all subsequent PGI-C ratings are stable or improved, 6. Part 2 Incidence of TEAEs, treatment-emergent AESIs, and SAEs, 7. Part 2 Change from baseline in clinical laboratory, vital sign, physical examination, and ECG parameters, 8. Part 2 Deucrictibant and deucrictibant metabolites plasma concentration-time profiles, 1. Part 3 Time to symptom relief, defined as PGI-C rating of at least “better” sustained within 12 hours post-treatment, 2. Part 3 Time to symptom relief, defined as PGI-S rating of at least 1 point reduction sustained within 12 hours post-treatment, 3. Part 3 Proportion of study drug-treated attacks achieving complete symptom resolution, defined as achieving PGI-S rating of “no symptoms” at 24 hours post-treatment, 15. Part 1 Deucrictibant and deucrictibant metabolites urine concentrations at Week 12

Source: https://euclinicaltrials.eu/ctis-public/view/2025-522051-26-00